EU clinical trial 2023-506632-32-00: PHASE III RANDOMIZED STUDY OF FOLFOXIRI PLUS BEVACIZUMAB AND ATEZOLIZUMAB VERSUS FOLFOXIRI PLUS BEVACIZUMAB AS FIRST-LINE TREATMENT OF UNRESECTABLE pMMR AND IMMUNOSCORE IC-HIGH METASTATIC COLORECTAL CANCER PATIENTS. The AtezoTRIBE2 Study
Sponsor: Fondazione GONO G.I. (Patient organisation/association). Phase: Therapeutic confirmatory (Phase III). Countries: Italy (ongoing, recruiting).
Therapeutic area(s): Diseases [C] - Digestive System Diseases [C06]; Diseases [C] - Neoplasms [C04]
Gender: Female, Male. Age: 18-64 years, 65+ years. Enrolment: 238.
Status: Ongoing, recruiting. Start date (EU): 2024-10-28. Decision date: 2024-08-09. Results received: No. Last updated: 2026-05-26.

Condition(s): Metastatic colorectal cancer
Product: IRINOTECAN, CALCIUM LEVOFOLINATE, OXALIPLATIN, ATEZOLIZUMAB, FLUOROURACIL, BEVACIZUMAB

Primary endpoint: The primary endpoint is Progression Free Survival (PFS)
Endpoint(s): Overall Toxicity Rate is defined as the percentage of patients, relative to the total of enrolled subjects, experiencing any adverse event, according to National Cancer Institute Common Toxicity Criteria (version 5.0)3, during the induction and the maintenance phases of treatment., Toxicity Rate is defined as the percentage of patients, relative to the total of enrolled subjects, experiencing a specific adverse event of grade 3/4, according to National Cancer Institute Common Toxicity Criteria (version 5.0)3, during the induction and the maintenance phases of treatment., Objective Response Rate (ORR) is defined as the percentage of patients, relative to the total of enrolled subjects, achieving a complete (CR) or partial (PR) response, according to RECIST 1.1 criteria1, during the induction and the maintenance phases of treatment. The determination of clinical response will be based on investigator reported measurements. Responses will be evaluated every 8 weeks., Immuno-related Objective Response Rate (irORR) is defined as the percentage of patients, relative to the total of enrolled subjects, achieving a complete (CR) or partial (PR) response, according to immune-modified RECIST criteria2, during the induction and the maintenance phases of treatment. The determination of clinical response will be based on investigator reported measurements. Responses will be evaluated every 8 weeks., Early Objective Response Rate (EOR) is defined as the percentage of patients, relative to the total of the enrolled subjects, achieving a ≥20% decrease in the sum of diameters of RECIST target lesions at week 8 compared to baseline., Depth of Response (DpR) is defined as the relative change in the sum of longest diameters of RECIST target lesions at the nadir, in the absence of new lesions or progression of non-target lesions, when compared with baseline., R0 Resection Rate is defined as the percentage of patients, relative to the total of enrolled subjects, undergoing secondary R0 resection of metastases. Secondary R0 surgery is defined as microscopically margin free complete surgical removal of all residual disease, performed during treatment or after its completion, allowed by tumoral shrinkage and/or disappearance of one or more lesions., Duration of Response (DoR) is defined as the time from first documentation of objective response (complete [CR] or partial [PR] response, per RECIST 1.11) to the first documentation of PD (per RECIST 1.1) or to death to any cause, whichever comes first., Overall survival (OS) is defined as the time from randomization to the date of death due to any cause. For patients still alive at the time of analysis, the OS time will be censored on the last date the patients were known to be alive., Quality of Life (QoL) assessed using the EORTC QLQ-C30 and the EORTC QLQ-CR29 questionnaires, will be evaluated from patients who have completed at least one questionnaire item at baseline and during the study period according to the arm they were assigned to by randomization through descriptive summary statistics., Time To Deterioration in Quality of Life (TTD) is defined as the time from baseline to the first onset of a 10-point or greater decrease from baseline for functional scales or a 10-point or greater increase for symptom scales or death.

Source: https://euclinicaltrials.eu/ctis-public/view/2023-506632-32-00